EU clinical trial 2023-510144-20-00: A Phase 1/2, open-label, 2-arm study evaluating BLU-263 as monotherapy and in combination with azacitidine, in patients with KIT altered hematologic malignancies
Protocol code: BLU-263-2101
Sponsor: Blueprint Medicines Corp. (Pharmaceutical company). Phase: Phase I and Phase II (Integrated)- Other. Countries: Belgium (ended), Spain (ended), France (ended), Netherlands (ended), Norway (ended), Germany (ended).
Therapeutic area(s): Diseases [C] - Hemic and Lymphatic Diseases [C15]
Gender: Female, Male. Age: 18-64 years, 65+ years. Enrolment: 41.
Status: Ended. Start date (EU): 2023-03-29. End date (EU): 2025-03-10. End date: 2025-03-11. Decision date: 2024-03-29. Results received: Yes. Last updated: 2024-09-09.
Decision dates by country: NL: 2024-03-29, NO: 2024-04-03, DE: 2024-04-08, BE: 2024-04-15, ES: 2024-04-01, FR: 2024-04-03

Condition(s): Advanced Systemic Mastocytosis
Product: AZACITIDINE

Primary endpoint: Monotherapy (Arm 1) (Dose Escalation): - The RD will be primarily determined by the number of DLTs in the first 28 days of treatment with BLU-263 monotherapy. Monotherapy (Arm 1) (Dose Escalation & Expansion): - Safety profile of BLU-263, as assessed by the type, frequency, severity, timing, and relationship to study drug of any AEs or SAEs, and changes in vital signs, ECGs, and safety laboratory tests - Pure pathological response rate for SM in selective KIT inhibitor-naïve patients, Combination (Arm 2) (Dose Escalation): - The RD will be primarily determined by the number of DLTs (during 28 days starting from Day 15 of C1 or Day 15 of C2) with BLU-263 in combination with azacitidine - Safety profile of BLU-263, as assessed by the type, frequency, severity, timing, and relationship to study drug of any AEs or SAEs, and changes in vital signs, ECGs, and safety laboratory tests, Combination (Arm 2) (Dose Expansion): - Safety profile of BLU-263, as assessed by the type, frequency, severity, timing, and relationship to study drug of any AEs or SAEs, and changes in vital signs, ECGs, and safety laboratory tests, frequency, severity, timing, and relationship to study drug of any AEs or SAEs, and changes in vital signs, ECGs, and safety laboratory tests
Endpoint(s): Monotherapy (Arm 1) (Dose Escalation & Expansion): - Overall response rate for AdvSM, using mIWG MRT-ECNM - Pharmacokinetic parameters of BLU-263,including Cmax, Tmax, AUC0-24, Vz/F, t½, CL/F, and accumulation ratio - Overall survival - Time-to-response, DOR, and PFS - Proportion of patients pursuing stem cell transplant, Combination (Arm 2) : - Overall response rate for SM, using mIWG-MRT-ECNM - Pure pathological response rate for SM - Pharmacokinetic parameters of BLU-263 and azacitidine including: Cmax, Tmax, AUC0-24, Vz/F, t½, CL/F, and accumulation ratio

Source: https://euclinicaltrials.eu/ctis-public/view/2023-510144-20-00